EU clinical trial 2022-500618-24-00: Prostate medication, metabolism and gut microbiota, PROMED.
Sponsor: Turku University Central Hospital (Hospital/Clinic/Other health care facility). Phase: Therapeutic use (Phase IV). Countries: Finland (ongoing, recruiting).
Therapeutic area(s): Diseases [C] - Male Urogenital Diseases [C12]
Gender: Male. Age: 18-64 years, 65+ years. Enrolment: 100.
Status: Ongoing, recruiting. Start date (EU): 2022-12-01. Decision date: 2022-08-10. Results received: No. Last updated: 2022-10-04.

Condition(s): prostate cancer, benign prostate hyperplasia
Product: FIRMAGON 120 mg powder and solvent for solution for injection, Duodart 0,5 mg/0,4 mg hårda kapslar, FINASTERIDE, DUTASTERIDE, FIRMAGON 80 mg powder and solvent for solution for injection

Primary endpoint: change of gut microbiota signature after two months of prostate medication (5-ARI, LhRH-analog/antagonist)
Endpoint(s): change of gut microbiota metabolism after two months of prostate medication (5-ARI, LhRH-analog/antagonist), PSA response to 5-ARI after 2 and 6 months of therapy, prostate volume change to 5-ARI treatment after 2 and 6 months of therapy, PSA response LhRH-analog/antagonist after 2 and 6 months of therapy

Source: https://euclinicaltrials.eu/ctis-public/view/2022-500618-24-00